EU clinical trial 2024-512244-36-00: A multiple ascending dose (MAD) safety, tolerability and efficacy study of VRDN-001, a humanized monoclonal antibody directed against the IGF-1 receptor, in normal healthy volunteers (NHVs) and subjects with thyroid eye disease (TED)
Protocol code: VRDN-001-101
Sponsor: Viridian Therapeutics Inc. (Pharmaceutical company). Phase: Phase II and Phase III (Integrated). Countries: Spain (ended), Germany (ended), France (ended), Netherlands (ended).
Therapeutic area(s): Diseases [C] - Eye Diseases [C11]
Gender: Female, Male. Age: 18-64 years, 65+ years. Enrolment: 48.
Status: Ended. Start date (EU): 2022-10-25. End date (EU): 2025-03-27. End date: 2025-04-05. Decision date: 2024-10-04. Results received: Yes. Last updated: 2025-05-12.
Decision dates by country: FR: 2024-10-04, DE: 2024-10-07, NL: 2024-10-09, ES: 2024-10-04

Condition(s): Thyroid eye disease (TED)
Product: SODIUM CHLORIDE, VRDN-001 (Insulin-like growth factor-1 receptor [IGF-1R] inhibitor), VRDN-001 (Insulin-like growth factor-1 receptor [IGF-1R] inhibitor)

Primary endpoint: - SAFETY ENDPOINTS Adverse Events (AEs) and Serious Adverse Events (SAEs) will be monitored and recorded throughout the duration of the study. All clinically significant changes in other safety measurements will be recorded as AEs., - PRIMARY EFFICACY ENDPOINT IN THE USA, CANADA AND CHINA IN THE PIVOTAL PORTION OF THE STUDY (THRIVE) Proptosis Responder Rate in the study eye (i.e., reduction of proptosis of ≥ 2 mm from baseline [without a corresponding increase of ≥ 2 mm in the fellow eye] as measured by exophthalmometer) at 3 weeks post the fifth infusion (i.e., Week 15), - AUS, EU AND UK: Overall Responder Rate comprised of Proptosis Responder Rate in the study eye (i.e., reduction of proptosis of ≥ 2 mm from baseline [without a corresponding increase of ≥ 2 mm in the fellow eye] as measured by exophthalmometer) at 3 weeks post the fifth infusion (i.e., Week 15) and Clinical Activity Responder Rate in the study eye (i.e., reduction in CAS ≥ 2 points from baseline [without a corresponding increase of ≥ 2 points in the fellow eye]) at 3 weeks post the 5 infusion
Endpoint(s): Key Secondary Endpoints in Australia, EU and UK in the Pivotal portion of the Study (THRIVE): • Change from Baseline in proptosis in the study eye as measured by exophthalmometer at Week 15, Change from baseline in CAS in the study eye at Week 15, Diplopia Resolution Rate at (i.e., reduction in Gorman Subjective Diplopia Score to 0 from baseline for participants with baseline Gorman Subjective Diplopia Score >0) Week 15, Proportion of participants with a CAS score of zero or one in the study eye at Week 15, Exploratory Endpoints in Australia, Canada, China, EU, UK and US in the Pivotal portion of the Study (THRIVE): • Proptosis Responder Rate in the study eye as measured by exophthalmometer) at Week 24 (12 weeks post fifth infusion), Week 36 (24 weeks post fifth infusion) and Week 52, Proptosis Responder Rate in the fellow eye (i.e., reduction of proptosis of ≥ 2 mm from baseline as measured by exophthalmometer) at Weeks 15, 24, 36 and 52, Durability of Proptosis Response in the study eye at Weeks 24, 36 and 52, Time to First Proptosis Response in the study eye, Clinical Activity Responder Rate in the study eye at Weeks 24, 36 and 52, Clinical Activity Responder Rate in the fellow eye at Weeks 15, 24, 36 and 52, Change from baseline in CAS in the study eye at Weeks 24, 36 and 52, Change from baseline in CAS in the fellow eye at Weeks 15, 24, 36 and 52, Time to first CAS Response in the study eye, Overall Responder Rate in the study eye at Weeks 24, 36 and 52, Overall Responder Rate in the fellow eye at Weeks 15, 24, 36 and 52, Time to First Overall Response in the study eye, Diplopia Resolution Rate at Weeks 24, 36 and 52, Proportion of participants with a CAS score of zero or one in the study eye at Weeks 24, 36 and 52, Proportion of participants with a CAS score of zero or one in the fellow eye at Weeks 15, 24, 36 and 52, Proptosis Response Rate in the study eye as measured by magnetic resonance imaging [MRI] or Computed Tomography [CT – where allowed by local health authorities] at Weeks 15, 24, 36 and 52, Change from Baseline in the following parameters at Weeks 15, 24, 36 and 52: - Proptosis in the study eye by MRI (or CT – where allowed by local health authorities), - Extraocular muscles in the study eye as determined by MRI (or CT – where allowed by local health authorities), - Orbital fat in the study eye as measured by MRI (or CT – where allowed by local health authorities), - Manual measurement of lid retraction in the study eye, - Graves' Orbitopathy-Quality of Life (GO-QoL) combined score, - GO-QoL activity subscale, - GO-QoL appearance subscale - EQ-5D-5L QoL questionnaire, - Visual Acuity (VA); - Gorman Subjective Displopia Score, • VRDN-001, IGF-1 and ADA at various time points pre- and post- infusions as described in Appendix 1C.

Source: https://euclinicaltrials.eu/ctis-public/view/2024-512244-36-00